EU clinical trial 2024-512084-31-00: INtravenous Contrast computed tomography versus native computed tomography in patients with acute Abdomen and impaired Renal functiOn (INCARO) – a multicentre, open-label, randomised controlled trial
Sponsor: University Of Helsinki (Educational Institution). Phase: Therapeutic use (Phase IV). Countries: Norway (authorised, recruiting), Finland (ongoing, recruiting).
Therapeutic area(s): Analytical, Diagnostic and Therapeutic Techniques and Equipment [E] - Diagnosis [E01]
Gender: Female, Male. Age: 18-64 years, 65+ years. Enrolment: 994.
Start date (EU): 2025-06-24. Decision date: 2025-06-24. Results received: No. Last updated: 2025-08-15.
Decision dates by country: FI: 2025-06-24, NO: 2025-06-26

Condition(s): Patients requiring emergency abdominal or body CT with eGFR 15-45 ml/min/1.73 m2. The eGFR is calculated from the last available plasma creatinine value taken maximum 24 hours before randomisation.
Product: Omnipaque 350 mg I/ml Injektionslösung

Primary endpoint: A composite outcome that combines all-cause mortality or renal replacement therapy within 90 days of contrast medium exposure
Endpoint(s): The most severe acute kidney injury (AKI) grade defined by KDIGO classification on plasma creatinine within 72 hours after CT, Any organ dysfunction defined by at least 2 mSOFA (modified Sequential Organ Failure Assessment) points excluding central nervous system 48 hours after CT, Alive and hospital-free days within 90 days after CT, Time from imaging to definitive treatment during hospital stay

Source: https://euclinicaltrials.eu/ctis-public/view/2024-512084-31-00